EU clinical trial 2024-516642-19-01: A randomized trial on Hemodynamic Optimization of cerebral Perfusion after Endovascular therapy in patients with acute ischemic stroke (HOPE study)
Protocol code: IIBSP-HOP-2021-01
Sponsor: Fundacio Institut De Recerca De L'Hospital De La Santa Creu I Sant Pau (Hospital/Clinic/Other health care facility). Phase: Therapeutic use (Phase IV). Countries: Spain (ended).
Therapeutic area(s): Diseases [C] - Nervous System Diseases [C10]
Gender: Female, Male. Age: 18-64 years, 65+ years. Enrolment: 814.
Status: Ended. Start date (EU): 2021-06-16. End date (EU): 2026-01-15. Decision date: 2024-11-11. Results received: No. Last updated: 2025-07-07.

Condition(s): Acute Ischemic Stroke
Product: Urapidil Accord 5 mg/ml solución inyectable y para perfusión EFG, Trandate 5mg/ml Solution for Injection, Fenilefrina Altan 0,1 mg/ml solución inyectable y para perfusión.

Primary endpoint: Direct comparison between the two arms of the trial with respect to mRS score at 90 days after randomization. This will be an intention to treat analysis. The main effect parameter will be the OR of change (shift analysis) in the direction of a better result in the mRS with its 95% confidence interval.

Source: https://euclinicaltrials.eu/ctis-public/view/2024-516642-19-01